EU clinical trial 2024-512045-16-00: A Phase 3, Open-label, Randomized Study of Lazertinib with Subcutaneous Amivantamab Compared with Intravenous Amivantamab in Patients with EGFR-mutated Advanced or Metastatic Non-small Cell Lung Cancer After Progression on Osimertinib and Chemotherapy
Protocol code: 61186372NSC3004
Sponsor: Janssen Cilag International (Pharmaceutical company). Phase: Therapeutic confirmatory (Phase III). Countries: Portugal (ended), France (ongoing, recruitment ended), Germany (ended), Spain (ended), Italy (ended), Poland (ongoing, recruitment ended).
Therapeutic area(s): Diseases [C] - Neoplasms [C04]
Gender: Female, Male. Age: 18-64 years, 65+ years. Enrolment: 76.
Start date (EU): 2022-08-18. Decision date: 2024-07-19. Results received: No. Last updated: 2026-03-31.
Decision dates by country: PT: 2024-08-14, PL: 2024-07-24, IT: 2024-07-22, ES: 2024-07-20, FR: 2024-07-26, DE: 2024-07-19

Condition(s): EGFR-mutated Advanced or Metastatic Non-small Cell Lung Cancer
Product: JNJ-61186372, JNJ-73841937, JNJ-61186372

Primary endpoint: Ctrough of amivantamab: at steady state (Cycle 4 Day 1) for all regions other than EU and others accepting Cycle 2 Day 1 and pre-dose on Cycle 2 Day 1 for EU and any other applicable region, AUCD1-D15 in Cycle 2

Source: https://euclinicaltrials.eu/ctis-public/view/2024-512045-16-00